EU clinical trial 2024-510835-23-00: A randomized, single dose, cross-over bioavailability study comparing the drug-drug interaction between telmisartan tablets, indapamide tablets, and amlodipine tablets when co-administered versus the administration of each product alone in three arms to healthy volunteers under fasting conditions.
Protocol code: 204-PKT-202301
Sponsor: Cepha s.r.o., PRO.MED.CS Praha a.s. (Pharmaceutical company). Phase: Human Pharmacology (Phase I)- Other. Countries: Czechia (ended).
Therapeutic area(s): Diseases [C] - Cardiovascular Diseases [C14]
Gender: Female, Male. Age: 18-64 years. Enrolment: 96.
Status: Ended. Start date (EU): 2024-06-19. End date (EU): 2024-09-17. Decision date: 2024-06-12. Results received: No. Last updated: 2024-06-12.

Condition(s): high blood pressure

Source: https://euclinicaltrials.eu/ctis-public/view/2024-510835-23-00